EU clinical trial 2024-515872-12-00: Clindamycin for the treatment of infections: the influence of rifampicin and obesity on PK/PD target attainment
Protocol code: S65747
Sponsor: UZ Leuven (Hospital/Clinic/Other health care facility). Phase: Therapeutic use (Phase IV). Countries: Belgium (ongoing, recruiting).
Therapeutic area(s): Analytical, Diagnostic and Therapeutic Techniques and Equipment [E] - Therapeutics [E02]; Diseases [C] - Bacterial Infections and Mycoses [C01]
Gender: Female, Male. Age: 18-64 years, 65+ years. Enrolment: 40.
Status: Ongoing, recruiting. Start date (EU): 2025-07-29. Decision date: 2025-01-14. Results received: No. Last updated: 2026-07-16.

Condition(s): Fracture related infections, Prosthetic joint infections, Hidradenitis suppurativa
Product: CLINDAMYCIN, RIFAMPICIN

Primary endpoint: Pharmacokinetic parameters (AUC, Vd, Clearance, Elimination half-life)
Endpoint(s): Effectiveness of treatment, Clinical cure

Source: https://euclinicaltrials.eu/ctis-public/view/2024-515872-12-00